EU clinical trial 2025-524723-52-00: LIBRETTO: Stimulan™ Local Antibiotic Delivery System Versus 4-Week Systemic Antibiotic Therapy for Diabetic Foot Osteomyelitis – A Prospective, Randomized, Controlled Trial
Sponsor: Pirkanmaan hyvinvointialue (Hospital/Clinic/Other health care facility). Phase: Therapeutic confirmatory (Phase III). Countries: Finland (authorised, recruitment pending).
Therapeutic area(s): Diseases [C] - Bacterial Infections and Mycoses [C01]; Diseases [C] - Nutritional and Metabolic Diseases [C18]
Gender: Female, Male. Age: 18-64 years, 65+ years. Enrolment: 84.
Status: Authorised, recruitment pending. Decision date: 2026-04-10. Results received: No. Last updated: 2026-06-23.

Condition(s): Diabetic Foot Osteomyelitis
Product: Gensumycin 40 mg/ml injektioneste, liuos, Cotrim forte tabletit, Meropenem AptaPharma 1 g injektio-/infuusiokuiva-aine, liuosta varten, Amoxin comp 500 mg / 125 mg tabletti, kalvopäällysteinen, Metronidazole Braun 5 mg/ml infuusioneste, liuos, Vancomycin MIP Pharma 1000 mg, Infuusiokuiva-aine, liuosta varten, Cefuroxim MIP Pharma 1500 mg injektio/infuusiokuiva-aine, liuosta varten, Kefexin 750 mg tabletti, kalvopäällysteinen, Piperacillin/Tazobactam Fresenius Kabi 4 g/0,5 g infuusiokuiva-aine, liuosta varten, Ciprofloxacin Orion 500 mg kalvopäällysteiset tabletit, Clindamycin Orion 300 mg kapseli, kova, Vancomycin MIP Pharma 500 mg, Infuusiokuiva-aine, liuosta varten, Doximed 100 mg tabletti, Trikozol 400 mg tabletit, Flucloxacillin Orion 1 g kalvopäällysteiset tabletit, Levofloxacin Orion 500 mg kalvopäällysteiset tabletit, Ceftriaxon Fresenius Kabi 2 g infuusiokuiva-aine, liuosta varten, Amoxicillin MIP Pharma 1000 mg tabletit

Primary endpoint: • Healed ulcer/osteomyelitis resolution at 12 and 24 weeks (no further antimicrobial treatment, stable wound closure)

Source: https://euclinicaltrials.eu/ctis-public/view/2025-524723-52-00